EU clinical trial 2024-511134-12-00: ETOP 14-18 CHESS: A multicentre single arm phase II trial assessing the efficacy of immunotherapy, chemotherapy and stereotactic radiotherapy to metastases followed by definitive surgery or radiotherapy to the primary tumour, in patients with synchronous oligo-metastatic non-small cell lung cancer
Protocol code: ETOP 14-18 CHESS
Sponsor: ETOP IBCSG Partners Foundation (Laboratory/Research/Testing facility). Phase: Therapeutic exploratory (Phase II). Countries: Netherlands (ongoing, recruitment ended), Spain (ongoing, recruitment ended), Italy (authorised, recruiting).
Therapeutic area(s): Diseases [C] - Respiratory Tract Diseases [C08]; Diseases [C] - Neoplasms [C04]
Gender: Female, Male. Age: 18-64 years, 65+ years. Enrolment: 28.
Start date (EU): 2023-12-20. Decision date: 2024-09-19. Results received: No. Last updated: 2026-03-04.
Decision dates by country: NL: 2024-09-19, ES: 2024-09-19, IT: 2024-10-07

Condition(s): NSCLC, synchronous oligo-metastatic
Product: IMFINZI 50 mg/mL concentrate for solution for infusion., IMJUDO 20 mg/ml concentrate for solution for infusion.

Primary endpoint: Progression-free survival at 1 year
Endpoint(s): Overall survival, Pattern of disease progression, Distant progression-free survival, Response to induction therapy, Overall response, Duration of response, Toxicity before and after surgery/radiotherapy, Symptom-specific and global quality of life

Source: https://euclinicaltrials.eu/ctis-public/view/2024-511134-12-00